EU clinical trial 2024-511286-11-00: A Study of HFB200301 as a Single Agent and in Combination With Tislelizumab in Adult Patients With Advanced Solid Tumors
Protocol code: HFB-200301-01
Sponsor: Hifibio Inc. (Laboratory/Research/Testing facility). Phase: Human Pharmacology (Phase I)- First administration to humans. Countries: Spain (ended).
Therapeutic area(s): Diseases [C] - Neoplasms [C04]
Gender: Female, Male. Age: 18-64 years, 65+ years. Enrolment: 188.
Status: Ended. Start date (EU): 2022-06-03. End date (EU): 2026-03-09. End date: 2026-03-10. Decision date: 2024-04-22. Results received: No. Last updated: 2025-07-24.

Condition(s): Advanced Solid Tumors

Source: https://euclinicaltrials.eu/ctis-public/view/2024-511286-11-00